EU clinical trial 2024-515251-37-00: Effect of obesity on the acetylation of COX1 and COX2 by aspirin as a biomarker of its effectiveness in chemoprevention and therapy in colon cancer: A Phase II Clinical Trial
Protocol code: PI20/01514
Sponsor: Fundacion Instituto De Investigacion Sanitaria Aragon (Laboratory/Research/Testing facility). Phase: Therapeutic exploratory (Phase II). Countries: Spain (ongoing, recruiting).
Therapeutic area(s): Diseases [C] - Neoplasms [C04]; Analytical, Diagnostic and Therapeutic Techniques and Equipment [E] - Therapeutics [E02]; Diseases [C] - Digestive System Diseases [C06]
Gender: Female, Male. Age: 18-64 years, 65+ years. Enrolment: 60.
Status: Ongoing, recruiting. Start date (EU): 2024-11-05. Decision date: 2024-11-05. Results received: No. Last updated: 2024-11-05.

Condition(s): Colorectal cancer
Product: OMEPRAZOLE, ACETYLSALICYLIC ACID

Primary endpoint: Effect of two courses (1 week/course) of different doses of ASA on COX-1 and COX-2 in patients diagnosed with colorectal cancer

Source: https://euclinicaltrials.eu/ctis-public/view/2024-515251-37-00